EU clinical trial 2023-504574-38-00: A research study to evaluate the effects of single doses of NNC0614-0001 in healthy adult volunteers, and participants with hereditary haemochromatosis type 1.
Protocol code: NN7614-7656
Sponsor: Novo Nordisk A/S (Pharmaceutical company). Phase: Human Pharmacology (Phase I)- Other. Countries: Austria (ended).
Therapeutic area(s): Diseases [C] - Congenital, Hereditary, and Neonatal Diseases and Abnormalities [C16]; Diseases [C] - Hemic and Lymphatic Diseases [C15]
Gender: Female, Male. Age: 18-64 years. Enrolment: 66.
Status: Ended. Start date (EU): 2024-09-06. End date (EU): 2026-05-13. Decision date: 2024-07-29. Results received: No. Last updated: 2025-12-29.

Condition(s): Hereditary haemochromatosis (HH) type 1

Source: https://euclinicaltrials.eu/ctis-public/view/2023-504574-38-00